EU clinical trial 2023-505232-36-00: A Phase 3, Randomized, Double-blind, Active-Comparator-Controlled Clinical Study to Evaluate the Efficacy and Safety of Bomedemstat (MK-3543) versus Hydroxyurea in Cytoreductive Therapy Naïve Essential Thrombocythemia Participants
Protocol code: MK-3543-007
Sponsor: Merck Sharp & Dohme LLC (Pharmaceutical company). Phase: Therapeutic confirmatory (Phase III). Countries: Denmark (ongoing, recruitment ended), Italy (ongoing, recruitment ended), Sweden (ongoing, recruitment ended), France (ongoing, recruitment ended), Germany (ongoing, recruitment ended), Spain (ongoing, recruitment ended), Poland (ongoing, recruitment ended), Austria (ongoing, recruitment ended), Hungary (ongoing, recruitment ended).
Therapeutic area(s): Diseases [C] - Hemic and Lymphatic Diseases [C15]
Gender: Female, Male. Age: 18-64 years, 65+ years. Enrolment: 153.
Status: Ongoing, recruitment ended. Start date (EU): 2024-11-15. Decision date: 2024-09-30. Results received: No. Last updated: 2026-05-07.
Decision dates by country: ES: 2024-10-07, DE: 2024-10-01, SE: 2024-10-03, AT: 2024-10-07, HU: 2024-10-03, IT: 2024-10-02, PL: 2024-10-07, DK: 2024-10-02, FR: 2024-09-30

Condition(s): Essential thrombocythemia
Product: MK-3543, HYDROXYCARBAMIDE, Placebo for hydroxycarbamide, MK-3543, MK-3543, MK-3543, Placebo for Bomedemstat

Primary endpoint: Durable Clinicohematologic Response (DCHR) Rate.
Endpoint(s): Change From Baseline in Myelofibrosis Symptom Assessment Form version 4.0 (MFSAF v4.0) Individual Fatigue Symptom Item Score., Change From Baseline in Patient-reported Outcomes Measurement Information System (PROMIS) Fatigue SF-7a Total Fatigue Score., Change From Baseline in MFSAF v4.0 Total Symptom Score., Duration of Clinicohematologic Response (DOCHR)., Duration of Hematologic Remission (DOHR)., Number of Participants Who Experience Thrombotic Events., Number of Participants Who Experience Major Hemorrhagic Events., Disease Progression Rate., Number of Participants Who Experience One or More Adverse Events (AEs), Number of Participants Who Discontinue Study Intervention Due to an AE.

Source: https://euclinicaltrials.eu/ctis-public/view/2023-505232-36-00